EU clinical trial 2023-506580-34-00: A study to evaluate how the body absorbs, breaks down and removes drug as well as safety and tolerability when two drugs are administered together as an injection under the skin to healthy participants.
Sponsor: Janssen - Cilag International (Pharmaceutical company). Phase: Human Pharmacology (Phase I)- Other. Countries: Belgium (ended).
Therapeutic area(s): Diseases [C] - Immune System Diseases [C20]
Gender: Female, Male. Age: 18-64 years. Enrolment: 105.
Status: Ended. Start date (EU): 2024-01-04. End date (EU): 2025-01-14. Decision date: 2023-11-17. Results received: No. Last updated: 2024-10-16.

Condition(s): Healthy Volunteers

Source: https://euclinicaltrials.eu/ctis-public/view/2023-506580-34-00